EU clinical trial 2024-511788-27-01: Pilot Study of Liver Fibrosis Stage Assessment by Fibroblast Activation Protein Imaging in Patients With Biopsy for Suspected or Proven Nonalcoholic Steatohepatitis
Sponsor: CHRU De Nancy (Hospital/Clinic/Other health care facility). Phase: Therapeutic exploratory (Phase II). Countries: France (ongoing, recruiting).
Therapeutic area(s): Diseases [C] - Nutritional and Metabolic Diseases [C18]; Diseases [C] - Digestive System Diseases [C06]
Gender: Female, Male. Age: 18-64 years, 65+ years. Enrolment: 72.
Status: Ongoing, recruiting. Start date (EU): 2025-06-03. Decision date: 2025-03-10. Results received: No. Last updated: 2025-03-10.

Condition(s): non-alcoholic hepatic steatosisalcoholic hepatic steatosis

Primary endpoint: Measurement of 68Ga-FAPI-46 uptake intensity, with Standardized Uptake Values maximum (SUVmax), average (SUVmean) and peak (SUVpeak), in areas centered on biopsy sites, the reference then being a classification of fibrosis stages determined by centralized biopsy rereading (stages 4, 3, 2 and < 2 (Kleiner, 2005; Bedossa, 2012).
Endpoint(s): 1. SUV threshold values associated with each of the four fibrosis histological stage groups (stages 4, 3, 2 and < 2) by the naive Bayes classifier., 2. Location of the uptake zone with maximum activity (SUVmax and SUVPIC zones, respectively), and of the homogeneity of SUV distribution over the liver volume (histogram of liver voxels per SUV value category)., 3. Search, on whole-body images, for 68Ga-FAPI-46 uptake foci located outside the tracer's normal elimination zones (urinary excretory tracts), and which may correspond to abnormal areas of fibrosis and/or inflammation, or even cancer (this new tracer has already demonstrated a good ability to detect many cancers)., 4. Intra-class correlation coefficients and their 95% confidence intervals., 5. Variation in the degree of prediction of the four groups of histological stages of fibrosis when the 68Ga-FAPI-46 PET/CT variables are added to the variables derived from the usual clinico-biological scores (CBC, FIB-4, Fibrometer) and pulse elastometry (Fibroscan®)., 6. Identical to the main objective, the reference being the histological fibrosis score determined in the SAF score, and patients being grouped into quartiles according to this score.

Source: https://euclinicaltrials.eu/ctis-public/view/2024-511788-27-01